EU clinical trial 2023-508791-11-00: A placebo-controlled, double-blinded, randomized, dose-finding trial using a combination of apocynin and paeonol (APPA) for the treatment of knee osteoarthritis
Sponsor: Akl Research & Development Limited (Pharmaceutical company). Phase: Therapeutic exploratory (Phase II). Countries: Denmark (ended).
Therapeutic area(s): Diseases [C] - Musculoskeletal Diseases [C05]
Gender: Female, Male. Age: 18-64 years, 65+ years. Enrolment: 170.
Status: Ended. Start date (EU): 2024-07-08. End date (EU): 2025-06-23. End date: 2025-06-24. Decision date: 2024-04-30. Results received: Yes. Last updated: 2025-01-24.
Decision dates by country: DK: 2024-05-24

Condition(s): Knee osteoarthritis
Product: Matching placebo, APPA, Panodil, filmovertrukne tabletter 500 mg (Ny formulering)

Primary endpoint: The primary endpoint of this trial is the change from baseline in WOMAC pain sub-score (sum of questions 1 to 5) of the target knee as evaluated at week 12.
Endpoint(s): Changes from baseline in WOMAC total score and the WOMAC function and stiffness scores at week 12, Changes from baseline in constant, intermittent and total OA pain assessed by ICOAP scores at week 12, Changes from baseline in WOMAC pain weight-bearing score (questions 1, 2, and 5) and non-weight bearing score (questions 3 and 4) at week 12, Change from baseline in the weekly mean of the average daily NRS pain intensity at Week 12, Area-under-effect curves of the weekly mean of the average daily NRS pain intensity at Week 12, OMERACT-OARSI responder rate at week 12, Total number of days where rescue medication was reported used for treatment of target knee pain, Total dose of rescue medication calculated as the sum of tablets used, based on pill counts, Changes from baseline in the Patient Global Assessment (PGA) score at week 12, Changes from baseline in quality of life assessed by the EQ5D at week 12, Nature, incidence and severity of AEs, Changes in laboratory safety parameters, vital signs, ECG parameters, and weight

Source: https://euclinicaltrials.eu/ctis-public/view/2023-508791-11-00